EU clinical trial 2024-520282-31-00: ESA - Esmolol versus Sufentanil on the quality of recovery after laparoscopic cholecystectomy during anesthesia with oro-tracheal intubation on ambulatory
Protocol code: 87RI_24_0041
Sponsor: Centre Hospitalier Et Universitaire De Limoges (Hospital/Clinic/Other health care facility). Phase: Therapeutic use (Phase IV). Countries: France (ongoing, recruiting).
Therapeutic area(s): Phenomena and Processes [G] - Physiological processes [G07]
Gender: Female, Male. Age: 18-64 years, 65+ years. Enrolment: 120.
Status: Ongoing, recruiting. Start date (EU): 2025-10-23. Decision date: 2025-05-16. Results received: No. Last updated: 2026-04-07.

Condition(s): Laparoscopic Cholecystectomy
Product: ESMOCARD 100 mg/10 ml, solution injectable, Sufentanil Viatris 5 microgrammes/ml solution injectable

Primary endpoint: Quality of recovery questionnaire (fQoR-15) on D1 (day after surgery)
Endpoint(s): 1- Cumulative duration of the Visual Analogue Scale (VAS) > 3 and total dose of morphine 2-Presence of pharyngeal pain (= sore throat) in the recovery room and outpatient 3- Blood pressure surge with SBP > 180 mmHg and/or DBP > 110 mmHg 4- Tachycardia with HR > 100 bpm 5- Hypotension with SBP < 90 mmHg and/or DBP < 50 mmHg ), bradycardia with HR < 50 bpm ; Use of vasopressors intraoperatively

Source: https://euclinicaltrials.eu/ctis-public/view/2024-520282-31-00